EU clinical trial 2024-520230-29-00: A study to test how insulin NNC0471-0119 works in the body in participants with type 2 diabetes when given by an insulin pump.
Protocol code: NN1471-5026
Sponsor: Novo Nordisk A/S (Pharmaceutical company). Phase: Human Pharmacology (Phase I)- Other. Countries: Germany (ended).
Therapeutic area(s): Diseases [C] - Nutritional and Metabolic Diseases [C18]
Gender: Female, Male. Age: 18-64 years, 65+ years. Enrolment: 65.
Status: Ended. Start date (EU): 2025-07-01. End date (EU): 2026-03-10. Decision date: 2025-05-23. Results received: No. Last updated: 2026-07-14.

Condition(s): Diabetes mellitus type 2

Source: https://euclinicaltrials.eu/ctis-public/view/2024-520230-29-00